EU clinical trial 2025-520637-24-00: Use of a new diagnostic tool in the detection and characterization of endometriosis lesions. ENDO-TEP
Protocol code: RC31/23/0622
Sponsor: Centre Hospitalier Universitaire De Toulouse (Hospital/Clinic/Other health care facility). Phase: Therapeutic exploratory (Phase II). Countries: France (ongoing, recruiting).
Therapeutic area(s): Diseases [C] - Female Urogenital Diseases and Pregnancy Complications [C13]
Gender: Female. Age: 18-64 years. Enrolment: 20.
Status: Ongoing, recruiting. Start date (EU): 2026-03-23. Decision date: 2025-05-23. Results received: No. Last updated: 2025-05-23.

Condition(s): Endometriosis
Product: EstroTep 500 MBq/mL, solution injectable

Primary endpoint: Characterization of the hypermetabolism of lesions on PET by analysis of SUV: Hypermetabolism present or not and quantification
Endpoint(s): Analyzes of lesions in Immunohistochemistry (IHC) and results of in situ hybridization: Characterization of the markings (intensity, type of receptor expressed, etc.) for each lesion depending on the anatomical location., Analyzes of lesions in Immunohistochemistry and results of in situ hybridization: Characterization of the markings (intensity, type of receptor expressed, etc.) for each patient according to pain (VAS), Sensitivity of [18F]-FES PET/CT compared to that of MRI in the diagnosis of superficial and deep endometriosis lesions and according to their location, Degree of association between [18F] SUV intensity and ER expression (IHC) and pain intensity (VAS)

Source: https://euclinicaltrials.eu/ctis-public/view/2025-520637-24-00